EU clinical trial 2024-510950-29-00: A Double-Blind, Randomized, Placebo-Controlled, Multicenter, Outpatient, Parallel-Group Study to Assess the Efficacy and Safety of Staccato Alprazolam in Study Participants 12 Years of Age and Older With Stereotypical Prolonged Seizures
Protocol code: EP0162
Sponsor: UCB Biopharma (Pharmaceutical company). Phase: Therapeutic confirmatory (Phase III). Countries: France (ongoing, recruiting), Spain (ongoing, recruiting), Germany (ongoing, recruiting), Hungary (ongoing, recruiting), Czechia (ongoing, recruiting), Bulgaria (ongoing, recruiting), Poland (ongoing, recruiting), Italy (ongoing, recruiting).
Therapeutic area(s): Diseases [C] - Nervous System Diseases [C10]
Gender: Female, Male. Age: 0-17 years, 18-64 years, 65+ years. Enrolment: 126.
Status: Ongoing, recruiting. Start date (EU): 2022-07-21. Decision date: 2024-09-04. Results received: No. Last updated: 2026-05-25.
Decision dates by country: BG: 2024-09-13, CZ: 2024-09-05, DE: 2024-09-06, HU: 2024-09-09, IT: 2024-10-16, PL: 2024-10-09, ES: 2024-09-04, FR: 2024-09-05

Condition(s): Stereotypical prolonged seizure
Product: Placebo matching < Staccato® alprazolam > and without active substance, alprazolam

Primary endpoint: Treatment success for the treated seizure with no recurrence after 2 hours
Endpoint(s): Treatment success for treated seizure with no recurrence after 4 hours, Treatment success for treated seizure with no recurrence after 6 hours, Time from IMP administration to cessation of the treated seizure, Frequency of respiratory treatment emergent adverse events (TEAEs), Number of subsequent seizure(s) up to 2 hours after IMP administration, Time to first subsequent seizure up to 2 hours after IMP administration

Source: https://euclinicaltrials.eu/ctis-public/view/2024-510950-29-00